EU clinical trial 2023-510490-34-00: Using organoids to predict efficacy of adjuvant treatment to improve outcome in resectable pancreatic cancer (UNITEPANC)
Protocol code: UNITEPANC
Sponsor: Universitaetsklinikum Ulm AöR (Hospital/Clinic/Other health care facility). Phase: Therapeutic exploratory (Phase II). Countries: Germany (ongoing, recruiting).
Therapeutic area(s): Analytical, Diagnostic and Therapeutic Techniques and Equipment [E] - Investigative Techniques [E05]; Diseases [C] - Neoplasms [C04]; Diseases [C] - Digestive System Diseases [C06]
Gender: Female, Male. Age: 18-64 years, 65+ years. Enrolment: 92.
Status: Ongoing, recruiting. Start date (EU): 2025-09-29. Decision date: 2025-07-01. Results received: No. Last updated: 2025-07-01.

Condition(s): Patients with functionally resectable pancreatic ductal adenocarcinoma (PDAC) according to NCCN criteria and Ca19-9 <500 U/ml (without relevant cholestasis)
Product: CAPECITABINE, PACLITAXEL, IRINOTECAN, GEMCITABINE, CALCIUM FOLINATE, FLUOROURACIL, OXALIPLATIN

Primary endpoint: Trial part I: Feasibility of treatment selection by an organoid-based approach in the adjuvant setting within 12 weeks after surgery in more than 60% of the resected PDAC., Trial part II: DFS at 18 months from start of organoid-based adjuvant treatment.
Endpoint(s): Trial part I: Organoid establishment in more than 75% of the resected PDAC, Trial part I: Organoid expansion and characterization in more than 60% of the resected PDAC, Trial part I: Rate of organoid-based change of adjuvant treatment regimen from standard mFOLFIRINOX treatment, Trial part I: Comparison of organoid establishment, expansion and characterization as well as treatment outcome between the different sites establishing organoids, Trial part II: Time from surgery to start of adjuvant treatment, Trial part II: Rate of patients receiving adjuvant treatment, Trial part II: DFS in organoid-based treatment selection with and without mFOLFIRINOX, Trial part II: OS in organoid-based treatment selection with and without mFOLFIRINOX, Trial part II: Comparison of DFS and OS by organoid-based adjuvant treatment with historical controls from the PRODIGE 24 trial, Trial part II: Correlation of CT imaging (radiomics) with R0 resection rate, DFS, OS, Ca19-9 and biomarker behaviour, Trial part II: Health related quality of life (EORTC QLQ-PAN26, QLQ-C30 questionnaires), Trial part II: Safety and Toxicity of organoid-based adjuvant treatment

Source: https://euclinicaltrials.eu/ctis-public/view/2023-510490-34-00